EU clinical trial 2023-506088-33-01: Allogenic mesenchymal stem cell intraarticular injection for knee osteoarthritis therapy, an RCT explorative mode-of-action study
Sponsor: Aarhus University (Educational Institution). Phase: Phase I and Phase II (Integrated)- Other. Countries: Denmark (ongoing, recruitment ended).
Therapeutic area(s): Diseases [C] - Musculoskeletal Diseases [C05]
Gender: Female, Male. Age: 18-64 years, 65+ years. Enrolment: 80.
Status: Ongoing, recruitment ended. Start date (EU): 2024-03-07. Decision date: 2024-02-16. Results received: No. Last updated: 2024-02-16.

Condition(s): knee osteoarthritis
Product: MSC, adipose tissue, Natriumklorid ”B. Braun”, Natriumklorid Fresenius Kabi 9 mg/ml

Primary endpoint: Knee symptoms as evaluated by the Knee Injury and Osteoarthritis Score (KOOS), Pain diary (first 30 days after AD-MSC or placebo treatment), Adverse events will be collected the first year after AD-MSC or placebo treatment
Endpoint(s): Cartilage regeneration (MRI Osteoarthritis Knee Score), Quantitative MRI protocol, Pain as reported on the Numeric Rating Scale (NRS), Range of motion, Effusion tests (swelling), Knee diameter on the patellae (swelling), Atrophy (measure quadriceps muscle bulk 10 cm above the patellae top)

Source: https://euclinicaltrials.eu/ctis-public/view/2023-506088-33-01